EU clinical trial 2022-503072-84-00: A Phase 3, Double-Blind, Multicenter Study to Evaluate the Efficacy and Safety of CAEL-101 and Plasma Cell Dyscrasia Treatment Versus Placebo and Plasma Cell Dyscrasia Treatment in Plasma Cell Dyscrasia Treatment-Naïve Patients with Mayo Stage IIIa AL Amyloidosis
Protocol code: CAEL101-302
Sponsor: Alexion Pharmaceuticals Inc. (Pharmaceutical company). Phase: Therapeutic confirmatory (Phase III). Countries: Spain (ongoing, recruitment ended), Germany (ongoing, recruitment ended), Czechia (ongoing, recruitment ended), Poland (ongoing, recruitment ended), Greece (ongoing, recruitment ended), Austria (ongoing, recruitment ended), Italy (ongoing, recruitment ended), France (ongoing, recruitment ended).
Therapeutic area(s): Diseases [C] - Immune System Diseases [C20]
Gender: Female, Male. Age: 18-64 years, 65+ years. Enrolment: 83.
Status: Ongoing, recruitment ended. Start date (EU): 2021-02-13. Decision date: 2024-06-13. Results received: No. Last updated: 2026-07-28.
Decision dates by country: DE: 2024-06-14, ES: 2024-06-13, IT: 2024-06-24, CZ: 2024-06-17, PL: 2024-06-14, AT: 2024-06-18, FR: 2024-06-18, GR: 2024-07-04

Condition(s): stage IIIa cardiac AL amyloidosis
Product: CAEL-101, SODIUM CHLORIDE

Primary endpoint: A hierarchical combination of time to all-cause Mortality (ACM) and the frequency of cardiovascular hospitalizations (CVH). Incidence of treatment emergent adverse events (TEAEs) and serious adverse events (SAEs). Changes from baseline in vital signs, weight, clinical laboratory tests, and 12lead electrocardiograms (ECGs).
Endpoint(s): Time to ACM in Primary Evaluation Treatment Period (PETP), Frequency of CVH in PETP, Changes from baseline to Week 50 in the KCCQ-OS., Change from baseline to Week 50 in NTproBNP, Changes from baseline to Week 50 in GLS%., Changes from baseline to Week 50 in the 6MWT, Change from baseline to Week 50 in the SF-36v2 PCS

Source: https://euclinicaltrials.eu/ctis-public/view/2022-503072-84-00